EU clinical trial 2025-522818-23-00: A Randomized, Open-Label, Phase 3 Study of ZL-1310, a DLL3 Antibody Drug Conjugate (ADC), Compared to Investigator’s Choice Therapy in Participants with Relapsed Small Cell Lung Cancer
Protocol code: ZL-1310-003
Sponsor: Zai Lab (US) LLC (Pharmaceutical company). Phase: Therapeutic confirmatory (Phase III). Countries: Belgium (authorised, recruiting), Czechia (authorised, recruitment pending), Germany (authorised, recruiting), Denmark (authorised, recruitment pending), Greece (authorised, recruitment pending), Netherlands (authorised, recruiting), Poland (ongoing, recruiting), Spain (ongoing, recruiting), Austria (authorised, recruiting), Italy (authorised, recruiting), France (authorised, recruiting).
Therapeutic area(s): Diseases [C] - Neoplasms [C04]
Gender: Female, Male. Age: 18-64 years, 65+ years. Enrolment: 234.
Start date (EU): 2026-06-26. Decision date: 2026-06-08. Results received: No. Last updated: 2026-08-05.
Decision dates by country: AT: 2026-06-08, CZ: 2026-06-09, FR: 2026-06-12, DE: 2026-06-11, IT: 2026-06-08, PL: 2026-06-12, GR: 2026-06-10, BE: 2026-06-09, DK: 2026-06-08, ES: 2026-06-09, NL: 2026-06-10

Condition(s): Small Cell Lung Cancer (SCLC)
Product: ZL-1310, TOPOTECAN HYDROCHLORIDE, TOPOTECAN HYDROCHLORIDE, TOPOTECAN HYDROCHLORIDE

Primary endpoint: 1. Confirmed objective response rate (ORR) assessed by Blinded Independent Central Review (BICR) per Response Evaluation Criteria in Solid Tumors version 1.1 (RECIST v1.1), 2. Overall survival (OS)
Endpoint(s): 1. Duration of response (DoR) assessed by BICR and by the investigator per RECIST v1.1, 2. Progression-free survival (PFS) assessed by BICR and by the investigator per RECIST v1.1, 3. Confirmed ORR assessed by the investigator per RECIST v1.1, 4. Time to response (TTR) assessed by BICR and by the investigator per RECIST v1.1, 5. Confirmed CNS response and duration of CNS response assessed by BICR per Response Assessment in Neuro-Oncology for Brain Metastases (RANO-BM), 6. Occurrence of treatment-emergent adverse events (TEAEs) including Grade ≥3, serious, and fatal TEAEs. Note: TEAEs are graded according to the National Cancer Institute Common Terminology Criteria for Adverse Events version 5.0 (CTCAE v5.0), 7. Clinically significant changes in clinical laboratory tests, 8. Changes from baseline in EQ-5D-5L (EQ-5D-5L index and EQ visual analog scale [VAS]), 9. Changes from baseline in EORTC-QLQ-C30, 10. Changes from baseline in EORTC-QLQ-LC13, 11. Time to deterioration in patient-reported lung cancer symptoms as measured by EORTC-QLQ-C30 and EORTC-QLQ-LC13, 12. Time to deterioration in patient-reported HRQoL scores and physical functioning scores as measured by EORTC-QLQ-C30

Source: https://euclinicaltrials.eu/ctis-public/view/2025-522818-23-00